EU clinical trial 2022-501362-22-00: 22104: A Randomized, Double-blind, Placebo-controlled, Multicenter Phase 2b/3 Study to Evaluate the Efficacy and Safety of Izokibep in Subjects with Active Psoriatic Arthritis
Protocol code: 22104
Sponsor: Acelyrin Inc. (Pharmaceutical company). Phase: Phase II and Phase III (Integrated). Countries: Hungary (ended), Czechia (ended), Poland (ended), Spain (ended), Germany (ended), Bulgaria (ended).
Therapeutic area(s): Diseases [C] - Musculoskeletal Diseases [C05]
Gender: Female, Male. Age: 18-64 years, 65+ years. Enrolment: 78.
Status: Ended. Start date (EU): 2023-04-18. End date (EU): 2024-10-03. End date: 2024-10-04. Decision date: 2023-03-29. Results received: Yes. Last updated: 2024-10-16.
Decision dates by country: PL: 2023-04-03, DE: 2023-03-29, HU: 2023-03-30, ES: 2023-04-03, CZ: 2023-03-30, BG: 2023-04-03

Condition(s): Psoriatic Arthritis
Product: Izokibep, Placebo

Primary endpoint: ACR50 at Week 16
Endpoint(s): • Resolution of enthesitis (LEI = 0) at Week 16 • PsAID response at Week 16 • PASI90 at Week 16 • HAQ-DI change from baseline to Week 16 • ACR20 at Week 16 • TEAEs, events of interest, and SAEs • Laboratory values and vital signs at collected timepoints • Treatment-emergent ADAs

Source: https://euclinicaltrials.eu/ctis-public/view/2022-501362-22-00